EU clinical trial 2024-514108-15-01: In vivo biological standardization of Dermatophagoides allergen extracts.
Protocol code: API-EAD-2024-01
Sponsor: Asac Pharmaceutical Inmunology S.A. (Pharmaceutical company). Phase: Therapeutic exploratory (Phase II). Countries: Spain (ongoing, recruiting).
Therapeutic area(s): Analytical, Diagnostic and Therapeutic Techniques and Equipment [E] - Diagnosis [E01]
Gender: Female, Male. Age: 18-64 years. Enrolment: 60.
Status: Ongoing, recruiting. Start date (EU): 2025-04-11. Decision date: 2025-03-14. Results received: No. Last updated: 2026-04-15.

Condition(s): Allergies
Product: Diagnóstico prick Dermatophagoides farinae 40 HEP/ml, Diagnóstico prick control positivo, Diagnóstico prick Dermatophagoides pteronyssinus 40 HEP/ml, Diagnóstico prick control negativo

Primary endpoint: The area of the wheal (mm2) that occurs at the cutaneous level after the administration of the extracts in the prick test for the calculation of the primary endpoint., Estimation of the dose/response relationship in each patient; regression analysis of area values versus concentration in PNU/ml., Determination of the theoretical concentration of extract that produces a papule equivalent to that produced by a solution of histamine at 10 mg/ml
Endpoint(s): Safety assessment through descriptive analysis of adverse reactions that could occur during the course of the study

Source: https://euclinicaltrials.eu/ctis-public/view/2024-514108-15-01